EU clinical trial 2025-521460-36-00: Prospective randomized study on sexual health and self-perceived quality of life (PROMs) in patients treated for cervical cancer
Protocol code: Providence
Sponsor: Fundacio De Recerca Clinic Barcelona-Institut D’Investigacions Biomediques August Pi I Sunyer (Laboratory/Research/Testing facility). Phase: Therapeutic use (Phase IV). Countries: Spain (ongoing, recruiting).
Therapeutic area(s): Diseases [C] - Female Urogenital Diseases and Pregnancy Complications [C13]
Gender: Female. Age: 18-64 years, 65+ years. Enrolment: 120.
Status: Ongoing, recruiting. Start date (EU): 2026-05-08. Decision date: 2025-05-09. Results received: No. Last updated: 2025-05-09.

Condition(s): Cervical cancer
Product: ESTRIOL, ESTRADIOL HEMIHYDRATE, PROMESTRIENE, PROGESTERONE, ESTRADIOL VALERATE

Primary endpoint: Global score on the FSFI (Female Sexual Function Index) form at the end of the first year after treatment.
Endpoint(s): Score on the FSFI form at diagnosis, after treatment (defined as baseline level: 1 month after surgery and 3 months after treatment with radiotherapy ± systemic treatment), at 6 and 12 months after treatment. The score in each of the sexual response domains that make up the FSFI (subjective desire and stimulus, lubrication, orgasm, satisfaction, and pain or discomfort) will also be evaluated individually., Score on the quality of life forms (EORTC QLQ-30, Cx-24, Cervantes- Reduced) at diagnosis, after treatment (baseline level), at 6 months and 12 months after treatment. The score on each of the 5 functional scales (physical functioning, daily activities, emotional functioning, cognitive functioning and social functioning), 3 symptom scales (fatigue, pain and nausea, vomiting), the global health status scale and the 6 independent items of EORTC QLQ-30, Adherence to multimodal treatment in the intervention arm, defined as the percentage of patients in the intervention arm who have undergone each of the items included in the multimodal treatment., Adverse effects with the use of treatments, assessing their number, severity and type (A - Augmented; B - Bizarre), Vaginal Health Index (VHI) score and thickness measured by ultrasound, for assessment of vaginal trophism at diagnosis, after treatment (baseline level), at 6 and 12 months after treatment.

Source: https://euclinicaltrials.eu/ctis-public/view/2025-521460-36-00